EU clinical trial 2023-506138-65-00: Impact of trimetazidine on endothelial function and biomarkers correlating with the prognosis of heart failure with preserved ejection fraction
Protocol code: NBK531/2/2022
Sponsor: Medical University Of Gdansk (Educational Institution). Phase: Therapeutic use (Phase IV). Countries: Poland (ended).
Therapeutic area(s): Diseases [C] - Cardiovascular Diseases [C14]
Gender: Female, Male. Age: 18-64 years, 65+ years. Enrolment: 468.
Status: Ended. Start date (EU): 2025-02-20. End date (EU): 2025-11-21. Decision date: 2024-01-12. Results received: No. Last updated: 2025-05-25.

Condition(s): Heart failure with preserved ejection fraction
Product: Trimeductan MR, 35 mg, tabletki o zmodyfikowanym uwalnianiu, Placebo for Trimeductan MR 35/Placebo dla Trimeductan MR 35

Primary endpoint: Time to hospitalization due to heart failure exacerbation or cardiovascular death.
Endpoint(s): Time to hospitalization for cardiovascular reasons; Time to hospitalization for any reason; Time to cardiovascular death; Time to death from any cause; EQ-5D score; KCCQ-12 score, NYHA Class, CCS Class; Level of biomarkers related to endothelial function; Inflammation biomarkers levels; Level of biomarkers associated with heart failure; Endothelial function parameters (FMD); Microcirculation Function Parameters (LSCI); Left ventricular systolic function parameters (ejection fraction

Source: https://euclinicaltrials.eu/ctis-public/view/2023-506138-65-00